EU clinical trial 2025-524232-20-00: REGENOVAR: A Phase I/II Study of Ubamatamab Plus Carboplatin, Paclitaxel, and Bevacizumab as Salvage Therapy in Ovarian Cancer with Poor Response to First-Line Chemotherapy.
Protocol code: Gineco-ov133b
Sponsor: Asso De Recherche Cancers Gynecologiques (Laboratory/Research/Testing facility). Phase: Phase I and Phase II (Integrated)- First administration to humans. Countries: France (authorised, recruitment pending).
Therapeutic area(s): Diseases [C] - Neoplasms [C04]
Gender: Female. Age: 18-64 years, 65+ years. Enrolment: 43.
Status: Authorised, recruitment pending. Decision date: 2026-06-04. Results received: No. Last updated: 2026-06-04.

Condition(s): Patients with poor prognostic ovarian cancers based on the tumor primary chemonsensitivity and incomplete debulking surgery.
Product: CARBOPLATIN, BEVACIZUMAB, FILGRASTIM, PACLITAXEL, Ubamatamab, Ubamatamab

Primary endpoint: Treatment emergent adverse events according to NCI CTCAE version 6.0., Dose-limiting toxicities (DLT) occurring during the DLT period (first 4 weeks of treatment)., The recommended dose for phase II trial (RP2D) of ubamatamab in combination with carboplatin-paclitaxel-bevacizumab., Objective response rate (ORR): Percentage of patients experiencing complete (CR) or partial response (PR) as the best overall radiological response after 3 cycles of ubamatamab in combination with carboplatin-paclitaxel-bevacizumab based on RECIST 1.1 criteria.
Endpoint(s): Treatment emergent Adverse events according to NCI CTCAE version 6.0 during the whole treatment period., Objective response rate (ORR): Percentage of patients experiencing complete (CR) or partial response (PR) as the best overall radiological response during the whole study treatment period based on RECIST 1.1 criteria., Duration of response in patients experiencing an objective response: Time from first objective response to first objective documented disease progression (based on RECIST v1.1 criteria), or to death (regardless of the cause in the absence of disease progression)., Disease control rate (DCR): Percentage of patients experiencing complete (CR) or partial response (PR) or stable disease (SD) as the best overall radiological response during the whole treatment period based on RECIST 1.1 criteria., Percentage of patients operated with late cytoreductive surgery (after 3 cycles of the study regimen), and among them the percentage of patients operated with complete surgery without any macroscopic residual lesion., Progression-free survival (PFS): Time from treatment start until the date of event defined as the first objective documented disease progression (based on RECIST v1.1 criteria) or death (regardless of the cause in the absence of progression). Patients who have not progressed or died at the time of analysis will be censored at the time of the latest date of assessment from their last evaluable RECIST assessment., Overall survival (OS): Time from the date from treatment start until death regardless of the cause. Any patient not known to have died at the time of analysis will be censored based on the last recorded date on which the patient was known to be alive., Progression-free survival during subsequent line of treatment (PFS-ST): Time from the start of the subsequent line of treatment until the date of event defined as the first objective documented progression (based on RECIST v1.1), or death (regardless of the cause in the absence of progression).

Source: https://euclinicaltrials.eu/ctis-public/view/2025-524232-20-00